EU clinical trial 2025-521748-39-00: SGLT-2i, Heart, Improvement of Cardiovascular Autonomic Neuropathy
Protocol code: SHICAN
Sponsor: Universita Cattolica Del Sacro Cuore (Educational Institution). Phase: Therapeutic use (Phase IV). Countries: Italy (ongoing, recruiting).
Therapeutic area(s): Phenomena and Processes [G] - Metabolism [G03]; Diseases [C] - Nutritional and Metabolic Diseases [C18]
Gender: Female, Male. Age: 18-64 years, 65+ years. Enrolment: 80.
Status: Ongoing, recruiting. Start date (EU): 2025-11-14. Decision date: 2025-07-21. Results received: No. Last updated: 2025-12-09.

Condition(s): type 2 diabetes
Product: SEMAGLUTIDE, EMPAGLIFLOZIN, SEMAGLUTIDE, SITAGLIPTIN, INSULIN DEGLUDEC, PIOGLITAZONE, CANAGLIFLOZIN, ERTUGLIFLOZIN, PIOGLITAZONE, EMPAGLIFLOZIN, SEMAGLUTIDE, DAPAGLIFLOZIN, INSULIN ASPART, INSULIN LISPRO, SEMAGLUTIDE, LINAGLIPTIN, INSULIN GLARGINE, INSULIN GLARGINE

Primary endpoint: Endpoint related to Objective #1: to verify the effect of SGLT-2is on HRV as shown by the difference in LF:HF ratio (a frequency domain measured as improvement of 20% in LF:HF ratio from baseline to end of treatment (6 months)., Endpoint related to Objective #2: to verify the effect of SGLT-2 on CAN progression as shown by the improvement in at least one of the three CART parameter AND an improvement in glucose variability from baseline to end of treatment (6 months)
Endpoint(s): to assess the results of SGLT2i treatment on pancreatic beta cell function (i.e., glucose sensitivity and insulin secretion parameters including those derived from the Mixed Meal Test (MMT)) in patients with and without CAN after 6 months intervention with SGLT2i., to assess the difference in glycemic variability expressed as mean amplitude of glycemic excursions (MAGE) measured for 2 weeks flash glucose monitoring at baseline and after 6 months of treatment with SGLT-2i., to explore difference in CAN progression expressed as changes in cardiovascular autonomic reﬂex tests (CARTs) as defined by: a) expiration/inspiration (E/I) ratio, b) 30:15 ratio and c) Valsalva ratio.

Source: https://euclinicaltrials.eu/ctis-public/view/2025-521748-39-00